EU clinical trial 2022-501692-35-00: INSTA-MD: INflammation-based Stratification for immune-Targeted Augmentation in Major Depressive disorder
Protocol code: INSTA-MD
Sponsor: University Of Antwerp (Educational Institution). Phase: Therapeutic confirmatory (Phase III). Countries: Belgium (ongoing, recruiting).
Therapeutic area(s): Psychiatry and Psychology [F] - Mental Disorders [F03]
Gender: Female, Male. Age: 18-64 years. Enrolment: 240.
Status: Ongoing, recruiting. Start date (EU): 2023-09-21. Decision date: 2023-06-05. Results received: No. Last updated: 2026-01-29.

Condition(s): Major Depressive Disorder (MDD)
Product: Minocycline EG 100 mg Filmtabletten, Celecoxib EG 200 mg capsules, hard, Placebo, hard capsule

Primary endpoint: Change in severity of depression measured as change in the HDRS-17 between baseline and endpoint, Rates of remission (HDRS≤7) at endpoint
Endpoint(s): Change in severity (IDS-30SR) Change in severity of depression measured as change in the IDS-30SR score [Time Frame: T0 -> T6 (12 weeks)], Response rate (HDRS-17) Rates of response (50% reduction in HDRS score from baseline) or partial response (25% reduction) at endpoint [Time Frame: T0 -> T6 (12 weeks)], Sleep (PSQI) [Time Frame: T0 -> T6 (12 weeks)], Anxiety (STAI) [Time Frame: T0 -> T6 (12 weeks)], Metabolic outcomes BMI, waist circumference, triglyceride, cholesterol, HDL and LDL levels, and fasting glucose [Time Frame: T0 -> T6 (12 weeks)], Symptom profiles (IDS-SR) [Time Frame: T0 -> T6 (12 weeks)], Therapy compliance (MARS) [Time Frame: T0 -> T6 (12 weeks)], Adverse effects [Time Frame: T0 -> T6 (12 weeks)], biomarker outcomes: cytokine concentrations, oxidative stress and metabolic markers, Core assessment of psychomotor change (CORE) [Time Frame: T0 -> T6 (12 weeks)]

Source: https://euclinicaltrials.eu/ctis-public/view/2022-501692-35-00